EU clinical trial 2023-504888-16-00: A Phase 1b/2 Multicenter, Open-label, Dose-escalation and Dose expansion Study to Evaluate the Safety, Tolerability, Pharmacokinetics, Immunogenicity, and Antitumor Activity of Trastuzumab Deruxtecan (T-DXd) Monotherapy and Combinations in Adult Participants with HER2-expressing Gastric Cancer (DESTINY-Gastric03)
Protocol code: D967LC00001
Sponsor: AstraZeneca AB (Pharmaceutical company). Phase: Phase I and Phase II (Integrated)- Other. Countries: Netherlands (ongoing, recruitment ended), Italy (ongoing, recruitment ended), Poland (ongoing, recruitment ended), Germany (ongoing, recruitment ended), Spain (ongoing, recruitment ended).
Therapeutic area(s): Diseases [C] - Neoplasms [C04]
Gender: Female, Male. Age: 18-64 years. Enrolment: 154.
Status: Ongoing, recruitment ended. Start date (EU): 2020-10-05. Decision date: 2024-10-08. Results received: No. Last updated: 2026-05-25.
Decision dates by country: PL: 2024-11-13, IT: 2024-10-14, NL: 2024-10-09, DE: 2024-10-09, ES: 2024-10-08

Condition(s): Patients with Human Epidermal Growth Factor Receptor 2 (HER2)-expressing gastric, GEJ and esophageal cancer
Product: OXALIPLATIN, CISPLATIN, OXALIPLATIN, IMFINZI 50 mg/mL concentrate for solution for infusion., PEMBROLIZUMAB, CAPECITABINE, TRASTUZUMAB, OXALIPLATIN, Rilvegostomig, CAPECITABINE, FLUOROURACIL, volrustomig, DS-8201a

Primary endpoint: Part 1: Occurrence of adverse events (AEs) and serious adverse events (SAEs), graded according to NCI CTCAE v5.0, dose-limiting toxicities (DLTs), and changes from baseline in laboratory parameters, vital signs, and electrocardiogram (ECG) results, Part 2, Part 3, Part 4 and Part 5: Endpoint assessed by Investigator per RECIST v1.1: Confirmed Objective Response Rate (ORR)
Endpoint(s): Part 1: Endpoints assessed by Investigator per RECIST v1.1: Confirmed Objective ResponseRate (ORR), Disease control rate (DCR), Duration of response (DoR), Progression-freesurvival (PFS), Overall survival (OS), Part 2, Part 3, Part 4 and Part 5: Endpoints assessed by Investigator per RECISIT v1.1: Diseasecontrol rate (DCR), Duration of response (DoR), Progression-free survival (PFS), Overallsurvival (OS), Part 2, Part 3, Part 4 and Part 5: Occurrence of adverse events (AEs) and serious adverse events(SAEs), dose-limiting toxicities (DLTs) and changes from baseline in laboratory parameters, vital signs, body weight and electrocardiogram (ECG) results, Part 2, Part 3, Part 4 and Part 5: -Serum concentration of T-DXd, total anti-HER2 antibody, and MAAA-1181a in all arms; -Serum concentration of durvalumab in study arms including T-DXd in combination with durvalumab; -Serum concentrations of volrustomig and rilvegostomig in study arms including T-DXd incombination with volrustomig and T-DXd in combination with rilvegostomig,, -Presence of ADAs for T-DXd, durvalumab, volrustomig and rilvegostomig (in study arms including T-DXd and durvalumab T-DXd and volrustomig, and T-DXd and rilvegostomig, respectively) -Comparison of ORR, DCR, DoR, PFS, OS between participants using local HER2 test results and central HER2 test results from tumor samples with evaluable results

Source: https://euclinicaltrials.eu/ctis-public/view/2023-504888-16-00